EU clinical trial 2023-509961-19-00: Investigation of pharmacokinetics, safety and tolerability of a single subcutaneous dose of NNC0487-0111 in participants with various degrees of renal impairment and normal renal function.
Protocol code: NN9490-7611
Sponsor: Novo Nordisk A/S (Pharmaceutical company). Phase: Human Pharmacology (Phase I)- Other. Countries: Germany (ended).
Therapeutic area(s): Diseases [C] - Nutritional and Metabolic Diseases [C18]
Gender: Female, Male. Age: 18-64 years, 65+ years. Enrolment: 42.
Status: Ended. Start date (EU): 2024-07-18. End date (EU): 2025-02-24. Decision date: 2024-06-25. Results received: No. Last updated: 2025-06-12.
Decision dates by country: DE: 2024-08-09

Condition(s): Obesity and Diabetes mellitus Typ 2

Source: https://euclinicaltrials.eu/ctis-public/view/2023-509961-19-00